EU clinical trial 2023-504086-23-00: Efficacy and safety of bezafibrate 400 mg and bezafibrate 200 mg as adjunctive treatments in patients with primary biliary cholangitis and non-optimal biochemical response to ursodeoxycholic acid therapy: a 12-month, double-blind, randomized, placebo-controlled trial with a 12-month, double-blind, placebo-free extension phase - BEZURSO 2
Protocol code: APHP220822
Sponsor: Assistance Publique Hopitaux De Paris (Hospital/Clinic/Other health care facility). Phase: Therapeutic confirmatory (Phase III). Countries: France (ongoing, recruiting).
Therapeutic area(s): Diseases [C] - Digestive System Diseases [C06]
Gender: Female, Male. Age: 18-64 years, 65+ years. Enrolment: 130.
Status: Ongoing, recruiting. Start date (EU): 2025-03-27. Decision date: 2024-09-03. Results received: No. Last updated: 2026-03-11.

Condition(s): Subjects with PBC with a non-optimal response to UDCA.
Product: BEFIZAL L.P. 400 mg, comprimé enrobé à libération prolongée, BEZAFIBRATE LP 400 mg, BEFIZAL 200 mg, comprimé pelliculé, Placebo BEZAFIBRATE 200 mg

Primary endpoint: • Proportion of patients with a complete biochemical response defined by normal serum levels of alkaline phosphatase (ALP), gamma-glutamyl transpeptidase (GGT), aminotransferases (AST, ALT), and total bilirubin at 48 weeks of treatment.
Endpoint(s): 1. Changes from baseline to W48 in itch intensity mean of the last 24h assessed by NRS as recommended by IFSI SIG / EADV Task Force Pruritus., 2. Proportion of patients with normal levels of ALP at W48., 3. Changes from baseline to W48 in LSM assessed by Fibroscan.

Source: https://euclinicaltrials.eu/ctis-public/view/2023-504086-23-00